EU clinical trial 2024-515245-42-00: International open-label phase I dose escalation study of dinutuximab beta in combination with vincristine/doxorubicin/cyclophosphamide and ifosfamide/etoposide in pediatric, adolescent, and adult patients with GD2-positive Ewing sarcoma
Protocol code: CESS-GD2
Sponsor: GPOH gGmbH (Patient organisation/association). Phase: Human Pharmacology (Phase I)- Other. Countries: Sweden (authorised, recruitment pending), Germany (ongoing, recruiting), Austria (authorised, recruiting), Czechia (authorised, recruitment pending).
Therapeutic area(s): Diseases [C] - Neoplasms [C04]
Gender: Female, Male. Age: 0-17 years, 18-64 years, 65+ years. Enrolment: 18.
Start date (EU): 2025-04-24. Decision date: 2025-02-11. Results received: No. Last updated: 2026-07-08.
Decision dates by country: AT: 2025-02-17, CZ: 2025-02-12, SE: 2025-02-13, DE: 2025-02-11

Condition(s): Ewing Sarcoma
Product: DOXORUBICIN, MESNA, CYCLOPHOSPHAMIDE, VINCRISTINE SULFATE, DINUTUXIMAB BETA, ETOPOSIDE, IFOSFAMIDE, FILGRASTIM

Primary endpoint: The primary endpoint is the identification of the recommended phase II dose (RP2D) of dinutuximab beta in combination with vincristine, doxorubicin, and cyclophosphamide, as well as ifosfamide and etoposide, based on the evaluation of dose-limiting toxicities (DLTs), overall safety, and tolerability within the study population.
Endpoint(s): Progression-Free Survival (PFS): The time from the start of treatment until the first documented evidence of disease progression or death from any cause, whichever occurs first., Event-Free Survival (EFS): The time from the initiation of treatment to the occurrence of any treatment-related event, including disease progression, relapse, occurrence of a second malignancy, or death from any cause., Duration of Response (DOR): The time from the first documentation of a complete or partial response to the treatment until the first occurrence of disease progression or relapse.

Source: https://euclinicaltrials.eu/ctis-public/view/2024-515245-42-00